EU clinical trial 2024-515861-33-00: A Phase 2, Randomized, Multicenter, Study of Vosoritide in Children with Noonan Syndrome with Inadequate Growth During or After Human Growth Hormone Treatment
Protocol code: 111-211
Sponsor: Biomarin Pharmaceutical Inc. (Pharmaceutical company). Phase: Therapeutic exploratory (Phase II). Countries: France (ongoing, recruiting), Spain (authorised, recruiting), Germany (authorised, recruitment pending), Italy (ongoing, recruiting).
Therapeutic area(s): Diseases [C] - Musculoskeletal Diseases [C05]
Gender: Female, Male. Age: 0-17 years, 18-64 years. Enrolment: 40.
Start date (EU): 2025-03-25. Decision date: 2025-02-03. Results received: No. Last updated: 2026-06-24.
Decision dates by country: ES: 2025-02-05, IT: 2025-02-05, DE: 2025-02-04, FR: 2025-02-03

Condition(s): Noonan Syndrome
Product: Voxzogo 0.56 mg powder and solvent for solution for injection, modified recombinant human C-type natriuretic peptide (rhCNP), Voxzogo 1.2 mg powder and solvent for solution for injection

Primary endpoint: Change from baseline in AGV at 6 months
Endpoint(s): 1. Change from baseline in height and height Z score at 6 months, 2. Incidence of treatment-emergent adverse events, and results of laboratory and imaging assessments, over the course of the study, 3. Incidence of new diagnosis of hypertrophic cardiomyopathy in children with Noonan syndrome; Incidence of cardiac conditions requiring discontinuation of study treatment, 4. Change from baseline in height, height Z-score, and 12-month internal AGV over the course of the study, 5. Change from baseline in upper to lower body segment ratio over the course of the study; Change from baseline in arm span to height, ratio over the course of the study, 6. Change from baseline in height at each visit up to FAH; Change from baseline in height Z-score at each visit up to FAH; 12-month interval AGV summarized by age and sex up to FAH, 7. Tanner stage over the course of the study, 8. PK parameters (eg, Tmax, Cmax, AUC0-t, AUC0-inf, t1/2, CL/F, and Vz/F), 9. Change from pre-dose at prespecified timepoints in urine cGMP; Change from baseline at prespecified timepoints in serum CXM, 10. Change from baseline in bone age/chronological age at prespecified timepoints, 11a. Change from baseline in bone mineralization based on the following, as measured by DXA: • total body (less head) BMD Z-score, • lumbar spine BMD Z-score, • total body (less head) BMC, • lumbar spine BMC, • lower extremity BMD/BMC, 11b. Change in the growth plates (ie, monitoring for closure), long bone growth and bone morphology in X-rays of the lower extremities (bilateral, whole length); Incidence of bone-related events of special interest (fracture, slipped capital femoral epiphysis and avascular necrosis or osteonecrosis), 12. Change from baseline in the physical domain score and total score of the QoLISSY; Change from baseline in the physical and social domain scores and total score of the PedsQL; Change from baseline in PGI-S and CaGI S item scores; PGI-C and CaGI-C item scores; Change from baseline in PROMIS-SF Physical Activity score, 13. Change from baseline in KABC-II NVI scores

Source: https://euclinicaltrials.eu/ctis-public/view/2024-515861-33-00